EU clinical trial 2024-517963-21-00: Dehydroepiandrosterone (DHEA) as augmentation of standard antidepressants in treatment-resistant depression: a randomized controlled trial (DARE-Trial) - A multicenter, randomized, double-blind, placebo-controlled trial with group sequential design
Protocol code: DARE-Trial
Sponsor: Charite Universitaetsmedizin Berlin KöR (Hospital/Clinic/Other health care facility). Phase: Therapeutic confirmatory (Phase III). Countries: Germany (ongoing, recruiting).
Therapeutic area(s): Psychiatry and Psychology [F] - Mental Disorders [F03]
Gender: Female, Male. Age: 18-64 years, 65+ years. Enrolment: 320.
Status: Ongoing, recruiting. Start date (EU): 2026-06-03. Decision date: 2025-11-04. Results received: No. Last updated: 2025-12-23.

Condition(s): Treatment Resistant Depression (TRD)
Product: Biosteron, 25 mg, tabletki, P-Tabletten weiß 10 mm Lichtenstein

Primary endpoint: Change score from baseline to week 6 in Montgomery-Asberg-Depression Rating Scale (MADRS)
Endpoint(s): Response, defined as 50% MADRS score reduction from baseline; Remission, defined as MADRS score <10, Changes in BDI-II from baseline to week 6, CGI-S, CGI-I, PGIC, and SOFAS will be determined, and EuroQol-5 with MCID as well as ASEX will also be collected, Change in glucose, glycosylated hemoglobin (HbA1c), total, HDL- and LDL-cholesterol, C-reactive protein (CRP), and interleukin-6 levels from baseline to week 6, Safety endpoints of AE, tolerability and acceptability

Source: https://euclinicaltrials.eu/ctis-public/view/2024-517963-21-00